EU clinical trial 2024-517969-16-00: Evaluation of the bioavailability of two transdermal gel preparations containing 0.1% w/w estradiol under fasting conditions: Estradiol/INTERMED gel 0.1% w/w (Test) vs. ESTREVA® 0.1%, gel (Comparator). A monocentric, open, randomized, single dose, two-period, crossover trial in healthy postmenopausal women
Protocol code: CIM24001
Sponsor: CCDRD Cooperative Clinical Drug Research and Development AG, Ioulia And Irene Tseti Pharmaceutical Laboratories S.A. (Pharmaceutical company). Phase: Human Pharmacology (Phase I)- Other. Countries: Bulgaria (ended).
Therapeutic area(s): Phenomena and Processes [G] - Physiological processes [G07]
Gender: Female. Age: 18-64 years. Enrolment: 18.
Status: Ended. Start date (EU): 2025-03-12. End date (EU): 2025-04-15. Decision date: 2025-02-21. Results received: No. Last updated: 2025-02-21.

Condition(s): No therapeutic indication in the current trial with healthy volunteers.

Source: https://euclinicaltrials.eu/ctis-public/view/2024-517969-16-00